EU clinical trial 2024-516679-33-00: Phase 1-2 Study of the Safety, Pharmacokinetics, and Preliminary Activity of ASTX660 in Subjects with Advanced Solid Tumors and Lymphomas
Protocol code: ASTX660-01
Sponsor: Taiho Oncology Inc. (Pharmaceutical company). Phase: Phase I and Phase II (Integrated)- First administration to humans. Countries: Spain (ended), Italy (ended).
Therapeutic area(s): Diseases [C] - Neoplasms [C04]
Gender: Female, Male. Age: 18-64 years, 65+ years. Enrolment: 16.
Status: Ended. Start date (EU): 2017-12-01. End date (EU): 2025-11-25. Decision date: 2024-09-09. Results received: No. Last updated: 2025-11-11.
Decision dates by country: IT: 2024-09-23, ES: 2024-09-09

Condition(s): Advanced Solid Tumors and Lymphomas that are metastatic or unresectable: Cohort#1:Recurrent/metastatic head and neck squamous cell carcinoma; #2:Relapsed/refractory diffuse large B-cell lymphoma; #3:Progressive, refractory or relapsed peripheral T-cell lymphoma; #4:Relapsed/refractory cutaneous T-cell lymphoma; #5: Other tumor types that may have sensitivity to ASTX660; # 6: Cervical carcinoma not responsive/relapsed after standard therapy
Product: Tolinapant, Tolinapant

Primary endpoint: Incidence of SAEs.
Endpoint(s): PK parameters of ASTX660, including area under the concentration-time curve (AUC), maximum concentration (Cmax), minimum concentration (Cmin), time to maximum concentration (Tmax), elimination half-life (t½), and other secondary PK parameters of ASTX660 if data permit; analysis of ASTX660 metabolites if applicable., DOR, PFS, and overall survival (OS)., Percentage degradation of cIAP1 protein in PBMCs from baseline, in response to ASTX660 treatment. [applies to Phase 1 only]., Antitumor activity (ORR, DOR, and PFS) based on independent review committee (IRC) assessment: Phase 2 Cohort 3 Expansion using 2014 Lugano Classification with LYRIC criteria, and Phase 2 Cohort 4 Expansion using Global Response Score (skin, blood and node using Olsen classification and viscera using Lugano classification with LYRIC criteria., Antitumor activity (DOR and PFS) based on investigator assessment using the Lugano classification with LYRIC criteria (Phase 2 Cohort 3 Expansion), and Phase 2 Cohort 4 Expansion using Global Response Score (skin, blood and node using Olsen classification] and viscera using Lugano classification with LYRIC criteria ., Antitumor activity (ORR, DOR, and PFS) based on IRC assessment using the Lugano classification alone (Phase 2 Cohort 3 Expansion).

Source: https://euclinicaltrials.eu/ctis-public/view/2024-516679-33-00